EU clinical trial 2024-515827-12-00: Phase 1 Study of UniCAR02-T-CD123 in Patients With Selected CD123 Positive Hematologic Malignancies
Protocol code: UC02-123-01
Sponsor: AvenCell Europe GmbH (Pharmaceutical company). Phase: Human Pharmacology (Phase I)- First administration to humans. Countries: Germany (ended), Netherlands (ended).
Therapeutic area(s): Diseases [C] - Hemic and Lymphatic Diseases [C15]
Gender: Female, Male. Age: 18-64 years, 65+ years. Enrolment: 40.
Status: Ended. Start date (EU): 2020-01-28. End date (EU): 2025-04-11. Decision date: 2024-08-02. Results received: No. Last updated: 2025-01-23.
Decision dates by country: DE: 2024-08-13, NL: 2024-08-02

Condition(s): Acute Myeloid Leukemia (AML)

Source: https://euclinicaltrials.eu/ctis-public/view/2024-515827-12-00